EU clinical trial 2023-510408-32-02: Premixed glucagon/insulin solution for faster insulin absorption in Type 1 diabetes.
Sponsor: St. Olavs Hospital HF (Hospital/Clinic/Other health care facility). Phase: Therapeutic exploratory (Phase II). Countries: Norway (temporarily halted).
Therapeutic area(s): Diseases [C] - Hormonal diseases [C19]
Gender: Female, Male. Age: 18-64 years, 65+ years. Enrolment: 30.
Status: Temporarily halted. Start date (EU): 2025-04-01. Decision date: 2025-01-23. Results received: No. Last updated: 2026-01-16.

Condition(s): Type 1 diabetes
Product: GLUCAGON, Lyumjev 100 units/mL solution for injection in vial

Primary endpoint: The area under the glucose consumption curve and area under the insulin curve for the first 30 minutes.
Endpoint(s): Area under glucose consumption curve for any other time span during the first 4 hours, Area under insulin curve for any other time span during the first 4 hours, Pharmacokinetic estimates for insulin, Pharmacodynamic estimates for insulin

Source: https://euclinicaltrials.eu/ctis-public/view/2023-510408-32-02